EU clinical trial 2023-504044-34-00: Multicohort Study to Customize Ibrutinib Treatment Regimens for Patients with Previously Untreated Chronic Lymphocytic Leukemia
Protocol code: 54179060CLL2032
Sponsor: Janssen - Cilag International (Pharmaceutical company). Phase: Therapeutic exploratory (Phase II). Countries: Czechia (ongoing, recruiting), Spain (ongoing, recruiting), Hungary (ongoing, recruiting), Italy (ongoing, recruiting), France (ongoing, recruiting), Poland (ongoing, recruiting).
Therapeutic area(s): Diseases [C] - Neoplasms [C04]
Gender: Female, Male. Age: 18-64 years, 65+ years. Enrolment: 213.
Status: Ongoing, recruiting. Start date (EU): 2024-04-17. Decision date: 2023-11-29. Results received: No. Last updated: 2026-08-05.
Decision dates by country: CZ: 2023-11-29, IT: 2023-11-29, HU: 2023-11-30, ES: 2023-12-04, PL: 2023-12-01, FR: 2023-11-30

Condition(s): Untreated Chronic Lymphocytic Leukemia
Product: Venclyxto 100 mg film-coated tablets, IMBRUVICA 140 mg hard capsules, Venclyxto 100 mg film-coated tablets, Venclyxto 10 mg film-coated tablets, Venclyxto 50 mg film-coated tablets, JNJ-54179060

Primary endpoint: Best ORR by investigator assessment

Source: https://euclinicaltrials.eu/ctis-public/view/2023-504044-34-00